EU clinical trial 2023-507073-18-00: A novel COMBinATorial therapy with albumin and enoxaparin in patients with decompensated cirrhosis at high-risk of poor outcome (COMBAT trial).
Protocol code: COMBAT
Sponsor: European Foundation For The Study Of Chronic Liver Failure (Patient organisation/association). Phase: Therapeutic exploratory (Phase II). Countries: Spain (ongoing, recruitment ended), Italy (ongoing, recruitment ended), France (ongoing, recruitment ended), Germany (ongoing, recruitment ended).
Therapeutic area(s): Diseases [C] - Digestive System Diseases [C06]
Gender: Female, Male. Age: 18-64 years, 65+ years. Enrolment: 80.
Status: Ongoing, recruitment ended. Start date (EU): 2024-04-24. Decision date: 2023-12-22. Results received: No. Last updated: 2026-03-11.
Decision dates by country: DE: 2024-01-08, FR: 2024-01-09, ES: 2023-12-22, IT: 2024-01-08

Condition(s): Cirrhosis
Product: Albutein 200 g/l solución para perfusión., Enoxaparina Rovi 4.000 UI (40 mg)/0,4 ml solución inyectable en jeringa precargada

Primary endpoint: The percentage of subjects who experience at least 1 treatment-emergent adverse events (TEAE) or serious adverse events (SAE), The percentage of subjects who discontinue the study drug due to pulmonary edema, severe thrombocytopenia and/or major bleeding according to the definition by Shulman et al (56)
Endpoint(s): 90 and 180-days changes in prognostic scores from baseline (CLIF- C AD, MELD, MELD-Na), 30 days, 90 and 180-days incidence of hospital readmission and ICU admission (causes and length of stay), 90 and 180-days incidence of ACLF according to the EASL-CLIF criteria, 90 and 180-days overall and transplant-free survival, 90 and 180-days incidence and cumulative number of therapeutic paracenteses, 90 and 180-days incidence of major complication of cirrhosis (grade 2-4 HE, portal-hypertensive gastrointestinal bleedings, AKI, HRS-AKI, new-onset portal vein thrombosis), 90 and 180-days incidence of proven bacterial infection, 90 and 180-days changes in organ function from baseline: liver function variables: grade of ascites according to the criteria of the International Club of Ascites, grade of hepatic encephalopathy using the West Haven and Animal Naming Test (ANT), bilirubin and albumin serum levels, 90 and 180-days changes in organ function from baseline: renal function variables: BUN, serum creatinine and electrolytes. GFR will be estimated by the MDRD equations, 90 and 180-days changes in organ function from baseline: lung function variables: respiratory rate, fraction of inspired oxygen (FIO2) and pulse oximetric saturation, 90 and 180-days changes in organ function from baseline: coagulative variables: INR, aPTT, fibrinogen, platelet count, 90 and 180-days changes in organ function from baseline: hemodynamic variables: systolic, diastolic and mean arterial pressure and heart rate, 90 and 180-days incidence of liver- and non-liver related Serious Adverse Event (SAE), 90 and 180-days changes in frailty (Liver Frailty Index), 90 and 180-days changes in quality of life (EQ-5D, VAS), Total hospital costs during the 6-month period, cost predictors and cost drivers, 30, 90 and 180-days changes in systemic inflammation, 30, 90 and 180-days changes in blood and microRNA transcriptome, 30, 90 and 180-days changes in the metabolomic landscape, 30, 90 and 180-days changes in albumin structure and function, 30, 90 and 180-days changes in coagulation assays, 30, 90 and 180-days changes in extracellular vesicles, 30, 90 and 180-days changes in endothelial function

Source: https://euclinicaltrials.eu/ctis-public/view/2023-507073-18-00